EU clinical trial 2025-520954-12-00: Short-Term Anticoagulation versus Antiplatelet Therapy for Preventing Device Thrombosis Following Left Atrial Appendage Closure. The ANDES study.
Protocol code: 5072018
Sponsor: Centre Hospitalier Universite De Laval (Hospital/Clinic/Other health care facility). Phase: Therapeutic use (Phase IV). Countries: Spain (authorised, recruitment pending).
Therapeutic area(s): Diseases [C] - Cardiovascular Diseases [C14]
Gender: Female, Male. Age: 18-64 years, 65+ years. Enrolment: 250.
Status: Authorised, recruitment pending. Decision date: 2025-02-03. Results received: No. Last updated: 2025-02-03.

Condition(s): Atrial Fibrillation Device thrombosis post-Left Atrial Appendage Closure
Product: Dabigatran Etexilate GLN 150 mg hard capsules, ASPIRINE ARROW 75 mg, comprimé gastro-résistant, Clopidogrel Viatris 75 mg film-coated tablets, Apixaban Teva GmbH 5 mg filmdragerade tabletter, Edoxaban TAD 60 mg apvalkotās tabletes, Rivaroxaban Kéri 20 mg filmtabletta

Primary endpoint: Primary Efficacy Endpoint: Device thrombosis as evaluated by TEE 60 days after LAAC and analyzed in a central echo core lab (as-treated analysis), Primary Safety Endpoint :Adverse clinical events including all-cause mortality, stroke, bleeding, or device thrombosis* within 60 days after LAAC (intention-to-treat analysis) * As clinically evaluated and diagnosed by the center investigators and determining a treatment change
Endpoint(s): Device thrombosis as evaluated by TEE or computed tomography 12 months after LAAC, Ischemic events (stroke, TIA) at 2-months and 1-, 2-, 3-, 4-, 5-year follow-up, Bleeding events at 2-months and 1-, 2-, 3-, 4-, 5-year follow-up

Source: https://euclinicaltrials.eu/ctis-public/view/2025-520954-12-00